EU clinical trial 2024-519853-12-00: Statin Intervention for Severe Early-Onset Placental Insufficiency: A Randomized Controlled Trial Assessing daily Administration as a Treatment Strategy (STATIN-PRE trial)
Protocol code: IIBSP-PRE-2024-198
Sponsor: Fundacio Institut De Recerca De L'Hospital De La Santa Creu I Sant Pau (Hospital/Clinic/Other health care facility). Phase: Therapeutic confirmatory (Phase III). Countries: Spain (ongoing, recruiting).
Therapeutic area(s): Diseases [C] - Female Urogenital Diseases and Pregnancy Complications [C13]; Diseases [C] - Pathological Conditions, Signs and Symptoms [C23]
Gender: Female. Age: 18-64 years, 65+ years. Enrolment: 154.
Status: Ongoing, recruiting. Start date (EU): 2026-01-14. Decision date: 2025-06-13. Results received: No. Last updated: 2026-01-09.

Condition(s): intrauterine growth restriction, preeclampsia
Product: Pravastatina Kern Pharma 40 mg comprimidos EFG, Placebo Pravastatina

Primary endpoint: Days of prolongation of pregnancy between inclusion and delivery; continuous (days).

Source: https://euclinicaltrials.eu/ctis-public/view/2024-519853-12-00